EU clinical trial 2024-516472-15-00: A phase 1 glucose clamp trial investigating the bioequivalence of CVC-001 cartridge vs U.S.-Licensed Lantus® in healthy male volunteers
Protocol code: CVC-22-001
Sponsor: Civica Inc. (Pharmaceutical company). Phase: Human Pharmacology (Phase I)- Bioequivalence Study. Countries: Germany (ended).
Therapeutic area(s): Diseases [C] - Nutritional and Metabolic Diseases [C18]
Gender: Male. Age: 18-64 years. Enrolment: 76.
Status: Ended. Start date (EU): 2026-01-06. End date (EU): 2026-07-20. Decision date: 2025-12-12. Results received: No. Last updated: 2026-05-06.

Condition(s): Type 1 diabetes mellitus (healthy participants)

Source: https://euclinicaltrials.eu/ctis-public/view/2024-516472-15-00